EU clinical trial 2023-508129-28-00: A multi-center, open-label study to determine the dose and safety of oral asciminib in pediatric patients with Philadelphia chromosome positive chronic myeloid leukemia in chronic phase (Ph+ CML-CP), previously treated with one or more tyrosine kinase inhibitors.
Protocol code: CABL001I12201
Sponsor: Novartis Pharma AG (Pharmaceutical company). Phase: Phase I and Phase II (Integrated)- Other. Countries: Hungary (ended), France (ongoing, recruiting), Netherlands (ongoing, recruiting), Germany (ongoing, recruiting), Greece (ongoing, recruiting), Poland (ongoing, recruiting), Italy (ongoing, recruiting).
Therapeutic area(s): Diseases [C] - Neoplasms [C04]
Gender: Female, Male. Age: 0-17 years. Enrolment: 17.
Start date (EU): 2022-09-28. Decision date: 2024-05-28. Results received: No. Last updated: 2026-03-16.
Decision dates by country: PL: 2024-07-05, HU: 2024-06-04, NL: 2024-05-28, GR: 2024-08-07, IT: 2024-07-09, DE: 2024-05-29, FR: 2024-06-03

Condition(s): Pediatric patients with Philadelphia chromosome positive chronic myeloid leukemia in chronic phase (Ph+ CML-CP), previously treated with one or more tyrosine kinase inhibitors
Product: ASCIMINIB, ASCIMINIB HYDROCHLORIDE, Asciminib

Primary endpoint: Primary PK parameters of asciminib: AUClast, AUCtau, Secondary PK parameters of asciminib: Cmax, Tmax, Ctrough.
Endpoint(s): Number, seriousness, severity, and causality assessments of treatment-emergent adverse events and other safety data as considered appropriate., Activity: Hematologic and molecular responses., Questionnaire on acceptability and palatability after first dose, 4 and 52 weeks., Number, seriousness, severity, and causality assessments of treatment-emergent adverse events and other safety data as considered appropriate including growth and sexual maturation assessments.

Source: https://euclinicaltrials.eu/ctis-public/view/2023-508129-28-00